EU clinical trial 2022-500479-29-00: A Phase 2/3, Multicenter, Randomized, Dose Optimization (Part I), Double-blind (Part II) Study to Compare the Efficacy and Safety of Oral Azacitidine (Oral-Aza, ONUREG®) plus Best Supportive Care (BSC) versus Placebo plus BSC in Participants with IPSS-R Low- or Intermediate-risk Myelodysplastic Syndrome (MDS)
Protocol code: CA055-026
Sponsor: Celgene Corp. (Pharmaceutical company). Phase: Phase II and Phase III (Integrated). Countries: Greece (ended), Czechia (ended), Austria (ended), Germany (ongoing, recruitment ended), Spain (ended), Italy (ended), Denmark (ended), Sweden (ended), France (ongoing, recruitment ended), Poland (ended).
Therapeutic area(s): Diseases [C] - Hemic and Lymphatic Diseases [C15]
Gender: Female, Male. Age: 18-64 years, 65+ years. Enrolment: 166.
Start date (EU): 2023-03-28. Decision date: 2023-03-10. Results received: No. Last updated: 2025-11-04.
Decision dates by country: CZ: 2023-03-13, DK: 2023-03-10, PL: 2023-03-20, AT: 2023-06-26, IT: 2023-03-10, SE: 2023-03-13, ES: 2023-03-15, GR: 2023-03-15, DE: 2023-03-15, FR: 2023-03-13

Condition(s): International Prognostic Scoring System-Revised (IPSS-R) Low - or Intermediate - risk Myelodysplastic Syndrome (MDS)
Product: azacitidine, azacitidine, Azacitidine 200 mg tablet, Azacitidine 300 mg tablet - describe tablets

Primary endpoint: For Part I (Phase 2) - AEs evaluated using NCI CTCAE criteria, v.5.0, including TEAEs, laboratory assessments, and vital signs, For Part I (Phase 2) - Achievement of CR per IWG 2006 criteria within 6 cycles, For Part II (Phase 3) - Achievement of CR within 6 cycles
Endpoint(s): For Part I (Phase 2) - Achievement of OR within 6 cycles (CR, PR, mCR, HI-E, HI-P, H-IN per IWG 2006 criteria), best OR; OR duration, For Part I (Phase 2) - CR duration, For Part I (Phase 2) - Achievement of 84-day pRBC-TI within 6 cycles; pRBC-TI duration, For Part I (Phase 2) - Achievement of 84-day PLT-TI within 6 cycles; PLT-TI duration, For Part II (Phase 3) - Achievement of 84-day pRBC-TI within 6 cycles, For Part II (Phase 3) - pRBC-TI duration, For Part II (Phase 3) - Achievement of 84-day platelet-TI within 6 cycles, For Part II (Phase 3) - Platelet-TI duration, For Part II (Phase 3) - Achievement of pRBC transfusion reduction; pRBC transfusion reduction duration, For Part II (Phase 3) - CR duration, For Part II (Phase 3) - Achievement of OR within 6 cycles (CR, PR, mCR, HI-E, HI-P, H-IN per IWG 2006 criteria), best OR; OR duration, For Part II (Phase 3) - OS, EFS (event: death, AML, MDS-EB 2), time to AML, time to subsequent therapy, For Part II (Phase 3) - Iron parameters, For Part II (Phase 3) - AEs evaluated using NCI CTCAE criteria, v.5.0, including TEAEs, laboratory assessments and vital signs, For Part II (Phase 3) - Change from baseline in the FACT-An, QUALMS, and EQ-5D-5L, For Part II (Phase 3) - Evaluation of healthcare resource use (eg, hospitalization) associated with IP during study

Source: https://euclinicaltrials.eu/ctis-public/view/2022-500479-29-00